EU clinical trial 2024-517252-35-00: Unraveling the aesthetic mind in anhedonia, insights from pharmacological imaging of the human brain: A single-blind, randomized, placebo-controlled cross-over study
Protocol code: PSY-NIL-0010
Sponsor: Medical University Of Vienna (Educational Institution). Phase: Human Pharmacology (Phase I)- Other. Countries: Austria (authorised, recruitment pending).
Therapeutic area(s): Psychiatry and Psychology [F] - Mental Disorders [F03]
Gender: Female, Male. Age: 18-64 years. Enrolment: 70.
Status: Authorised, recruitment pending. Decision date: 2024-10-30. Results received: No. Last updated: 2024-10-30.

Condition(s): Depression

Source: https://euclinicaltrials.eu/ctis-public/view/2024-517252-35-00